EU clinical trial 2024-515335-29-00: A PHASE 2A, EXPLORATORY, TWO-PART, OPEN-LABLE TRIAL TO EVALUATE DOSE AND SAFETY OF NANOECHO PARTICLE-1 (FERUMOXTRAN) USING NANOECHO IMAGING DEVICE EXAMINATIONS OF RECTAL LYMPH NODES IN HEALTHY VOLUNTEERS (PART A) AND RECTAL CANCER PATIENTS (PART B).
Protocol code: NEIS001
Sponsor: NanoEcho AB (publ) (Pharmaceutical company). Phase: Therapeutic exploratory (Phase II). Countries: Sweden (ongoing, recruiting).
Therapeutic area(s): Diseases [C] - Neoplasms [C04]; Not possible to specify; Diseases [C] - Pathological Conditions, Signs and Symptoms [C23]
Gender: Female, Male. Age: 18-64 years, 65+ years. Enrolment: 45.
Status: Ongoing, recruiting. Start date (EU): 2024-10-16. Decision date: 2024-09-18. Results received: No. Last updated: 2025-11-27.

Condition(s): Rectal cancer
Product: NEP-1

Primary endpoint: Part A1: - Dose-response curve (normalised average nTrace value for lymph nodes with an even nTrace distribution)), Part A1: - Time -response curve (normalised average nTrace value for lymph nodes with an even nTrace distribution), Part B: Normalised average nTrace value (in healthy lymph nodes with an even nTrace distribution) corresponding to dose and time selection in Part A., Part A1: Dose-response curve (normalised average nTrace value for lymph nodes regardless of nTrace distribution), Part A1: Time -response curve (normalised average nTrace value for lymph nodes regardless of nTrace distribution), Part A2: Dose-response curve (normalised average nTrace value for lymph nodes with an even nTrace distribution) corresponding to dose and time selection in Part A1, Part A2: Time -response curve (normalised average nTrace value for lymph nodes with an even nTrace distribution) corresponding to dose and time selection in Part A1., Part A2: Dose-response curve (normalised average nTrace value for lymph nodes regardless of nTrace distribution) corresponding to dose and time selection in Part A1., Part A2: Time -response curve (normalised average nTrace value for lymph nodes regardless of nTrace distribution) corresponding to dose and time selection in Part A1., Part B: Normalised average nTrace value (in healthy lymph nodes regardless of nTrace distribution) corresponding to dose and time selection in Part A.
Endpoint(s): Part A1: At what size of lymph nodes and in which sections and fractions are lymph nodes detectable (B-mode), but no nTrace detectable in lymph nodes?, Part A1: At what size of lymph nodes and in which sections and fractions are nTrace detectable in lymph nodes?, Part A1: At what size of lymph nodes and in which sections and fractions are nTrace showing an even distribution in lymph nodes?, Part A1: Frequency, seriousness, and intensity of adverse events (AEs)., Part A1: Frequency and nature of device deficiencies (DDs)., Part A1: Clinically significant changes in vital signs, ECG, safety laboratory measurements (haematology, clinical chemistry, coagulation) and physical examination findings., Part A1: Result of user experience questionnaire, Part B:At what size of lymph nodes and in which sections and fractions are lymph nodes detectable (B-mode) but no nTrace detectable in lymph nodes?, Part B: At what size of lymph nodes and in which sections and fractions are nTrace detectable in lymph nodes?, Part B: At what size of lymph nodes and in which sections and fractions are nTrace showing an even distribution in lymph nodes?, Part B: Number of suspected lymph nodes detected by NanoEcho diagnostic method, historic MRI and pathology., Part B: True positive fraction (N+) (sensitivity) and true negative fraction (N0) (specificity) of identified lymph nodes as assessed by NEP-01 using NanoEcho Imaging Device in rectum using histopathology as true comparator., Part B: Size of detectable lymph node with metastases, Part B: Size of detectable metastases., Part B: How far off from the tumour is tumour infiltration detectable?, Part B: Frequency, seriousness and intensity of AEs., Part B: Frequency and nature of DDs., Part B: Clinically significant changes in vital signs, ECG, safety laboratory measurements (haematology, clinical chemistry, coagulation) and physical examination findings., Part B: Result of user experience questionnaire., Part A2: At what size of lymph nodes and in which sections and fractions are lymph nodes detectable (B-mode), but no nTrace detectable in lymph nodes?, Part A2: At what size of lymph nodes and in which sections and fractions are nTrace detectable in lymph nodes?, Part A2: At what size of lymph nodes and in which sections and fractions are nTrace showing an even distribution in lymph nodes?, Part A2: Identify which probe cover that gives the best visualised images and highest nTrace value., Part A2: Frequency, seriousness, and intensity of adverse events (AEs) for the IMP and the medical device., Part A2: Frequency and nature of device deficiencies (DDs)., Part A2: Clinically significant changes in vital signs, ECG, safety laboratory measurements (haematology, clinical chemistry, coagulation) and physical examination findings., Part B: To compare the proportion of lymph nodes with an even distribution and the normalised nTrace value in unhealthy nodes compared to healthy nodes., Part B: Normalised average nTrace value (in unhealthy lymph nodes regardless of nTrace distribution) corresponding to dose and time selection in Part A.

Source: https://euclinicaltrials.eu/ctis-public/view/2024-515335-29-00